EU clinical trial 2023-503229-21-00: A PHASE III, OPEN-LABEL, RANDOMIZED STUDY OF ATEZOLIZUMAB WITH LENVATINIB OR SORAFENIB VERSUS SORAFENIB OR LENVATINIB ALONE IN HEPATOCELLULAR CARCINOMA PREVIOUSLY TREATED WITH ATEZOLIZUMAB AND BEVACIZUMAB
Protocol code: MO42541
Sponsor: F. Hoffmann-La Roche AG (Pharmaceutical company). Phase: Therapeutic confirmatory (Phase III). Countries: Finland (ended), Spain (ended), Belgium (ended), France (ongoing, recruitment ended), Austria (ended), Greece (ended), Italy (ended), Bulgaria (ended), Estonia (ended), Germany (ended), Slovenia (ended), Croatia (ended).
Therapeutic area(s): Diseases [C] - Neoplasms [C04]
Gender: Female, Male. Age: 18-64 years, 65+ years. Enrolment: 270.
Start date (EU): 2021-05-06. Decision date: 2024-02-19. Results received: No. Last updated: 2026-05-22.
Decision dates by country: EE: 2024-02-22, FI: 2024-02-19, HR: 2024-02-20, DE: 2024-02-23, BG: 2024-02-23, SI: 2024-02-20, ES: 2024-02-19, FR: 2024-02-26, GR: 2024-04-02, AT: 2024-02-26, BE: 2024-02-23, IT: 2024-03-11

Condition(s): Unresectable hepatocellular carcinoma (HCC)
Product: Tecentriq 1,200 mg concentrate for solution for infusion, Nexavar 200 mg film-coated tablets, LENVIMA 4 mg hard capsules

Primary endpoint: 1.OS, defined as the time from randomization into the study to death from any cause
Endpoint(s): 1.PFS, defined as the time from randomization into the study to the first occurrence of disease progression or death from any cause, 2.ORR, defined as the proportion of patients with a best response of either complete or partial response, 3.TTP, defined as the time from randomization to the first occurrence of disease progression, 4.DOR, defined as the time from the first occurrence of a documented confirmed objective response to disease progression or death from any cause, 5. Time to confirmed deterioration (TCTD), of health-related quality of life (HRQoL), defined as the time from randomization to first confirmed deterioration, 6.Incidence and severity of adverse events (AEs), with severity determined according to national cancer institute common terminology criteria for adverse events version 5.0 (NCI CTCAE v5.0), 7. Incidence and severity of AEs, including adverse events for combination treatment, AEs related against atezolizumab and tyrosine kinase inhibitor (TKI)-related AEs according to (NCI CTCAE v5.0), 8.Incidence of vital sign abnormalities, 9.Incidence of clinical laboratory abnormalities, 10.Serum concentration of atezolizumab at specified timepoints, 11.Prevalence of anti-drug antibodies (ADAs) against atezolizumab at time of study entry, 12.Incidence of ADAs against atezolizumab during the study

Source: https://euclinicaltrials.eu/ctis-public/view/2023-503229-21-00